EU clinical trial 2024-516351-40-00: A Phase 1 Study of JNJ-70218902, a T Cell Redirecting Agent, in Advanced Stage Solid Tumors
Protocol code: 70218902EDI1001
Sponsor: Janssen Cilag International (Pharmaceutical company). Phase: Human Pharmacology (Phase I)- First administration to humans. Countries: Spain (ended).
Therapeutic area(s): Diseases [C] - Neoplasms [C04]
Gender: Male. Age: 18-64 years, 65+ years. Enrolment: 1.
Status: Ended. Start date (EU): 2020-07-15. End date (EU): 2025-09-16. End date: 2025-09-17. Decision date: 2024-09-16. Results received: No. Last updated: 2024-09-16.

Condition(s): Metastatic Castration-Resistant Prostate Cancer

Source: https://euclinicaltrials.eu/ctis-public/view/2024-516351-40-00